EU clinical trial 2024-512338-13-00: A Phase I, open-label, multi-center study of radiation dosimetry, safety, and tolerability of extended lutetium (177Lu) vipivotide tetraxetan treatment in chemo-naïve adults with metastatic castration-resistant prostate cancer: RADIOpharmaceutical DOSimetry Evaluation (RADIODOSE) study
Protocol code: CAAA617A12101
Sponsor: Novartis Pharma AG (Pharmaceutical company). Phase: Human Pharmacology (Phase I)- Other. Countries: Spain (ongoing, recruiting), Germany (ongoing, recruiting), Netherlands (ongoing, recruiting).
Therapeutic area(s): Diseases [C] - Neoplasms [C04]
Gender: Male. Age: 18-64 years, 65+ years. Enrolment: 63.
Status: Ongoing, recruiting. Start date (EU): 2024-11-11. Decision date: 2024-10-04. Results received: No. Last updated: 2025-10-20.
Decision dates by country: ES: 2025-01-27, NL: 2024-10-09, DE: 2024-10-04

Condition(s): Metastatic Castration-Resistant Prostate Cancer
Product: Locametz 25 micrograms kit for radiopharmaceutical preparation, Pluvicto 1 000 MBq/mL solution for injection/infusion

Primary endpoint: -Time activity curves (TACs) and absorbed radiation dose of AAA617 in organs., -Incidence and severity of adverse events (AEs) and serious AEs (SAEs), -AAA617 dose reductions, interruptions, discontinuations
Endpoint(s): -TACs and absorbed radiation doses of AAA617 in tumors, -Concentrations of AAA617 in blood over time and derived PK parameters from blood radioactivity data., -ORR is defined as the proportion of participants with best overall response (BOR) of confirmed complete response (CR) or partial response (PR) per investigator assessment and according to PCWG3 modified-RECIST v1.1., -DCR is defined as the proportion of CR, PR, stable disease or non-CR/non-PD per investigator assessment and according to PCWG3 modified-RECIST v1.1 assessment in soft tissue, lymph node, and visceral lesions., -DOR is defined as the duration of time between the date of the first documented BOR (CR or PR) per investigator assessment according to PCWG3 modified-RECIST v1.1 and the date of first documented progression or death due to any cause., -Radiographic progression free survival (rPFS) defined as the time from the date of first dose of study treatment to the date of the first documented radiographic disease progression as assessed by investigator and PCWG3 modified-RECIST v1.1 criteria or death due to any cause, whichever occurs first., -Prostate specific antigen (PSA) response is defined as proportion of participants who achieve any decrease from baseline that is confirmed by a second PSA measurement ≥4 weeks. participants with any decrease in PSA will also be summarized by visit., -Overall survival is defined as the time from the first dose of study treatment to death due to any cause., -Changes in safety laboratory parameters, vital signs, electrocardiogram (ECG)., -Duration of exposure to AAA617 and dose intensity.

Source: https://euclinicaltrials.eu/ctis-public/view/2024-512338-13-00